EU clinical trial 2025-521069-28-00: Randomised, crossover bioequivalence clinical trial of escitalopram 20 mg capsules versus escitalopram 20 mg film-coated tablets, after a single oral dose administration to healthy volunteers under fasting conditions
Protocol code: UECHUP-ESC/25-1
Sponsor: Alter Farmacia S.A. (Pharmaceutical company). Phase: Human Pharmacology (Phase I)- Bioequivalence Study. Countries: Spain (ended).
Therapeutic area(s): Psychiatry and Psychology [F] - Mental Disorders [F03]
Gender: Female, Male. Age: 18-64 years. Enrolment: 24.
Status: Ended. Start date (EU): 2025-03-21. End date (EU): 2025-04-16. Decision date: 2025-03-04. Results received: No. Last updated: 2025-03-14.
Decision dates by country: ES: 2025-03-14

Condition(s): Antidepressants

Source: https://euclinicaltrials.eu/ctis-public/view/2025-521069-28-00